EU clinical trial 2023-508455-38-00: An open-label study to assess safety and efficacy of SZC in paediatric patients with hyperkalaemia
Protocol code: D9481C00001
Sponsor: AstraZeneca AB (Pharmaceutical company). Phase: Therapeutic confirmatory (Phase III). Countries: Germany (ended), Romania (ongoing, recruiting), Spain (ongoing, recruiting), Poland (ended).
Therapeutic area(s): Diseases [C] - Nutritional and Metabolic Diseases [C18]
Gender: Female, Male. Age: 0-17 years. Enrolment: 58.
Start date (EU): 2019-09-12. Decision date: 2024-04-02. Results received: No. Last updated: 2026-05-22.
Decision dates by country: DE: 2024-04-04, ES: 2024-04-02, PL: 2024-04-09, RO: 2024-04-05

Condition(s): Hyperkalaemia
Product: AZD7270, AZD7270, Lokelma 5 g powder for oral suspension, AZD7270, Lokelma 5 g powder for oral suspension

Primary endpoint: CP primary endpoint: Normokalaemia achieved in the CP within 3 days (yes/no), 28-day MP primary endpoint:Serum potassium (S-K+) value within normokalaemia range (yes/no) at each of the last two scheduled visits in the MP
Endpoint(s): All phases secondary endpoint: S-K+ level at each scheduled visit, MP secondary endpoints: Change in serum aldosterone levels from baseline to Week 3 of the MP Change in serum electrolytes (including bicarbonate), and spot urinary pH and urinary electrolytes from baseline to week 3 of the MP, LTMP secondary endpoints: S-K+ value within normokalaemia range (yes/no) at each scheduled visit in the LTMP

Source: https://euclinicaltrials.eu/ctis-public/view/2023-508455-38-00